EU clinical trial 2023-504915-34-00: Dose-finding for dobutamine during transitional circulation in the very preterm infant
Protocol code: NeoCirc-002 TRIAL
Sponsor: Hospital Universitario La Paz (Hospital/Clinic/Other health care facility). Phase: Phase I and Phase II (Integrated)- Other. Countries: Spain (ongoing, recruiting).
Therapeutic area(s): Diseases [C] - Congenital, Hereditary, and Neonatal Diseases and Abnormalities [C16]
Gender: Female, Male. Age: 0-17 years. Enrolment: 30.
Status: Ongoing, recruiting. Start date (EU): 2024-06-20. Decision date: 2023-06-29. Results received: No. Last updated: 2026-02-20.

Condition(s): Neonates with haemodynamic insufficiency
Product: Dobutamine Generis 12.5 mg/mL Solution for Infusion

Primary endpoint: Short-term PD endpoint: Minimum dobutamine dose to reach and maintain an SVC flow above 55 ml/k/min on an echocardiogram performed at 1 and 3 hours after effective infusion of the allocated dose [A].
Endpoint(s): Proportion of neonates achieving and maintaining a clinically acceptable haemodynamic status [B] with the dobutamine infusion alone in the first 72 hours from birth., Absolute and relative frequencies of adverse events (AEs) and severe adverse events (SAEs), to be recorded and compared between groups, To determine the correlation between PK and PD.

Source: https://euclinicaltrials.eu/ctis-public/view/2023-504915-34-00